EU clinical trial 2024-514433-38-00: Assessment of the effect of Wharton's jelly mesenchymal stem cell preparation (WJMSCs) in the treatment of fibrotic interstitial lung diseases
Protocol code: NBK272/1/2021
Sponsor: Medical University Of Gdansk (Educational Institution). Phase: Phase I and Phase II (Integrated)- Other. Countries: Poland (ongoing, recruiting).
Therapeutic area(s): Diseases [C] - Respiratory Tract Diseases [C08]
Gender: Female, Male. Age: 18-64 years, 65+ years. Enrolment: 45.
Status: Ongoing, recruiting. Start date (EU): 2023-09-28. Decision date: 2024-11-07. Results received: No. Last updated: 2025-05-13.

Condition(s): fibrotic interstitial lung disease
Product: Ofev 100 mg soft capsules, solution 10% dimethylsulfoxide in 5% human albumin, allogeneic mesenchymal stem cells derived from Wharton's jelly, Esbriet 267 mg film-coated tablets

Primary endpoint: 1. Number and severity of adverse events in the treated group and the control / placebo group 2. Inhibition of the decline in FVC (reduction by less than 10% over the course of the study, reduction significantly less than in the placebo group) 3. Improving the quality of life 4. Annual survival
Endpoint(s): Evaluation of: - changes in FVC - quality of life of patients - number of exacerbations during the annual total - survival during annual follow-up - pharmacokinetics and pharmacodynamics of the MSC preparation after administration

Source: https://euclinicaltrials.eu/ctis-public/view/2024-514433-38-00